EU clinical trial 2023-507773-17-00: Pancreatic head resection or total pancreatectomy with islet autotransplantation (IATx) in patients with periampullary cancer and high risk profile for the development of postoperative pancreatic fistula (POPF) - XandTX Trial
Protocol code: TUD-XandTX-079
Sponsor: Technische Universitat Dresden (Educational Institution). Phase: Therapeutic exploratory (Phase II). Countries: Germany (ongoing, recruiting).
Therapeutic area(s): Diseases [C] - Digestive System Diseases [C06]; Diseases [C] - Neoplasms [C04]
Gender: Female, Male. Age: 18-64 years, 65+ years. Enrolment: 32.
Status: Ongoing, recruiting. Start date (EU): 2024-12-11. Decision date: 2024-04-18. Results received: No. Last updated: 2024-04-18.

Condition(s): Patients with perampullary carcinoma and a high-risk profile to develop postoperative pancreatic fistulas
Product: Autologous pancreatic islets

Primary endpoint: Duration between surgery and the date of the decision "fit for adjuvant treatment" (postoperative day X)
Endpoint(s): Duration between surgery and the actual start of adjuvant therapy, Perioperative morbidity and mortality, Number and type of adverse events and serious adverse events, Quality of life (post-surgery, EORTC QLQ-C30/Pan26), Metabolic outcome, Oncological long term course (60 months)

Source: https://euclinicaltrials.eu/ctis-public/view/2023-507773-17-00